EU clinical trial 2024-511223-34-00: A Norwegian trial Comparing Treatment Strategies for Carpal Tunnel Syndrome
Sponsor: Diakonhjemmet Sykehus AS (Hospital/Clinic/Other health care facility). Phase: Therapeutic use (Phase IV). Countries: Norway (ongoing, recruitment ended).
Therapeutic area(s): Diseases [C] - Nervous System Diseases [C10]; Diseases [C] - Musculoskeletal Diseases [C05]
Gender: Female, Male. Age: 18-64 years, 65+ years. Enrolment: 258.
Status: Ongoing, recruitment ended. Start date (EU): 2022-04-08. Decision date: 2024-06-19. Results received: No. Last updated: 2024-06-19.

Condition(s): Carpal Tunnel Syndrome
Product: Kenacort-T 40 mg/ml, injeksjonsvæske, suspensjon, Trica 20 mg/ml injeksjonsvæske, suspensjon, Lederspan 20 mg/ml injeksjonsvæske, suspensjon.

Primary endpoint: Successful treatment outcome after one year, defined as attainment of Boston Carpal Tunnel Questionnaire Symptom Score ≤ 1.5
Endpoint(s): Successful treatment result (as defined above) after 3, 6 and 24 months, Successful treatment result after one injection, and after two injections, Patients in the injection arm who have undergone surgery after 3 weeks, 3, 6, 12 and 24 months, Work performance/participation and health care utilization as outlined in section 8.8 at each, or a combination, of time points., Adverse events throughout the study, Patient-reported measures of symptoms and function, ultrasound and NCS measures as outlined in section 8.1 at each time point, Emitted CO2-equivalents per treatment strategy pathway.

Source: https://euclinicaltrials.eu/ctis-public/view/2024-511223-34-00